EU clinical trial 2023-510541-25-00: A Study of NX-5948 in Adults With Relapsed/Refractory B-cell Malignancies
Protocol code: NX-5948-301
Sponsor: Nurix Therapeutics Inc. (Pharmaceutical company). Phase: Human Pharmacology (Phase I)- First administration to humans. Countries: Netherlands (ongoing, recruiting), France (ongoing, recruiting), Italy (ongoing, recruiting), Spain (ongoing, recruiting), Poland (ongoing, recruiting).
Therapeutic area(s): Diseases [C] - Hemic and Lymphatic Diseases [C15]
Gender: Female, Male. Age: 18-64 years, 65+ years. Enrolment: 250.
Status: Ongoing, recruiting. Start date (EU): 2023-10-09. Decision date: 2024-03-07. Results received: No. Last updated: 2026-06-08.
Decision dates by country: ES: 2024-09-23, IT: 2024-09-17, NL: 2024-06-07, PL: 2024-09-22, FR: 2024-09-12

Condition(s): Relapsed/Refractory B-cell Malignancies

Source: https://euclinicaltrials.eu/ctis-public/view/2023-510541-25-00